EU clinical trial 2023-505758-17-00: ABCSG 63 / ERIKA: Elacestrant and RIbociclib in Ki67-tested endocrine responsive breAst cancer: An open-label, two-arm, randomized, phase II study of elacestrant plus ribociclib vs. AI (plus GnRH agonist in pre-/perimenopausal women and men) plus ribociclib as neoadjuvant therapy for endocrine-responsive HER2-negative early breast cancer
Protocol code: ABCSG 63
Sponsor: Verein Zur Praevention Und Therapie Boesartiger Erkrankungen Austrian Breast And Colorectal Cancer Study Group (Patient organisation/association). Phase: Therapeutic exploratory (Phase II). Countries: Austria (ongoing, recruitment ended), Germany (ongoing, recruitment ended).
Therapeutic area(s): Diseases [C] - Neoplasms [C04]
Gender: Female, Male. Age: 18-64 years, 65+ years. Enrolment: 120.
Status: Ongoing, recruitment ended. Start date (EU): 2025-08-21. Decision date: 2025-04-24. Results received: No. Last updated: 2026-05-25.
Decision dates by country: DE: 2025-04-24, AT: 2025-04-28

Condition(s): endocrine-responsive HER2-negative early breast cancer
Product: ORSERDU 86 mg film-coated tablets, LETROZOLE, ORSERDU 345 mg film-coated tablets, Kisqali 200 mg film-coated tablets, EXEMESTANE, ANASTROZOLE

Primary endpoint: Proportion of modified PEPI score of 0 at the time of surgery
Endpoint(s): Proportion of endocrine-responsive tumors (i.e., Ki-67 ≤10 %) determined by local pathology via C1D22 biopsy, Locally and centrally measured Ki-67 (via C1D22 visit biopsy), Proportion of RCB 0/I at the time of surgery determined by local pathology, Proportion of pCR at the time of surgery, Change of radiological tumor size from screening to 3 months of treatment and to pre-surgery

Source: https://euclinicaltrials.eu/ctis-public/view/2023-505758-17-00